EU clinical trial 2025-521527-74-00: EVALUATION OF OPIOID CONSUMPTION USING OBJECTIVE NOCICEPTIVE MONITORING IN PATIENTS INDICATED FOR DEEP SEDATION IN THE INTENSIVE CARE UNIT
Protocol code: Estudio SENOPI-UCI
Sponsor: Hospital Universitari De Girona Doctor Josep Trueta (Hospital/Clinic/Other health care facility). Phase: Phase III and phase IV (Integrated). Countries: Spain (authorised, recruitment pending).
Therapeutic area(s): Analytical, Diagnostic and Therapeutic Techniques and Equipment [E] - Anesthesia and Analgesia [E03]
Gender: Female, Male. Age: 18-64 years, 65+ years. Enrolment: 144.
Status: Authorised, recruitment pending. Decision date: 2025-07-04. Results received: No. Last updated: 2025-07-04.

Condition(s): NEUROCRITIC PATIENTS
Product: MIDAZOLAM, ISOFLURANE, PROPOFOL

Primary endpoint: Sedation variables:Respiratory, hemodynamic, neuromonitoring, and infectious status variables.
Endpoint(s): Observed Adverse Effects Throughout the Study:- Time to awakening and presence/absence of delirium during the patient's awakening process. - ICU length of stay. - Hospital length of stay. - ICU mortality. - Hospital mortality- Opiodis abstincence

Source: https://euclinicaltrials.eu/ctis-public/view/2025-521527-74-00